EU clinical trial 2022-502672-23-00: A Phase 1 Study of PRT2527 as Monotherapy and in Combination with Zanubrutinib or Venetoclax in Participants with Relapsed/Refractory Hematologic Malignancies
Protocol code: PRT2527-02
Sponsor: Prelude Therapeutics Inc. (Pharmaceutical company). Phase: Human Pharmacology (Phase I)- Other. Countries: Germany (ended), Poland (ended), Italy (ended), France (ended).
Therapeutic area(s): Diseases [C] - Neoplasms [C04]
Gender: Female, Male. Age: 18-64 years, 65+ years. Enrolment: 109.
Status: Ended. Start date (EU): 2023-10-18. End date (EU): 2026-01-21. End date: 2026-01-22. Decision date: 2023-09-14. Results received: No. Last updated: 2025-10-03.
Decision dates by country: DE: 2023-09-14, FR: 2023-09-18, IT: 2023-09-14, PL: 2023-09-18

Condition(s): Richter's Syndrome, Chronic Lymphocytic Leukemia (CLL), Mantle Cell Lymphoma (MCL), Acute myeloid leukemia (AML), Marginal zone lymphoma (MZL), T-cell lymphoma (TCL) subtypes, Myelodysplastic syndrome (MDS), MDS/myeloproliferative neoplasm (MPN) overlap syndrome, Chronic myelomonocytic leukemia (CMML), Small Lymphocytic Lymphoma (SLL), Aggressive B-Cell Non-Hodgkin's Lymphoma

Source: https://euclinicaltrials.eu/ctis-public/view/2022-502672-23-00